EU clinical trial 2024-517490-24-00: SEZanne: A Phase 2 Randomized, Open label, Multicenter Study to Evaluate the Optimal Dose, Safety, and Efficacy of ABBV-706 in Combination with Atezolizumab versus Standard of Care as First-Line Treatment in Subjects with Previously Untreated Extensive Stage Small Cell Lung Cancer (ES-SCLC)
Protocol code: M24-633
Sponsor: AbbVie Deutschland GmbH & Co. KG (Pharmaceutical company). Phase: Therapeutic exploratory (Phase II). Countries: Spain (ongoing, recruiting), Germany (ongoing, recruiting), Italy (authorised, recruiting), Poland (ongoing, recruiting), Belgium (ongoing, recruiting).
Therapeutic area(s): Diseases [C] - Neoplasms [C04]
Gender: Female, Male. Age: 18-64 years, 65+ years. Enrolment: 60.
Start date (EU): 2026-03-31. Decision date: 2026-03-18. Results received: No. Last updated: 2026-06-11.
Decision dates by country: BE: 2026-03-19, ES: 2026-03-25, PL: 2026-03-27, IT: 2026-05-25, DE: 2026-06-11

Condition(s): Small Cell Lung Cancer
Product: ABBV-706, CARBOPLATIN, ETOPOSIDE, CARBOPLATIN, ATEZOLIZUMAB

Primary endpoint: Progression-Free Survival (PFS) based on investigator assessment per RECIST v1.1.
Endpoint(s): Overall Response (OR) as Measured by Overall Response Rate (ORR) based on investigator assessment per RECIST v1.1., Duration of Response (DoR) based on investigator assessment per RECIST v1.1., Disease Control (DC) based on investigator assessment per RECIST v1.1., OS

Source: https://euclinicaltrials.eu/ctis-public/view/2024-517490-24-00